EU clinical trial 2026-525788-42-00: Thorough QT/QTc study with GLPG3667, placebo, and active comparator in healthy subjects
Protocol code: GLPG3667-CL-122
Sponsor: Galapagos (Pharmaceutical company). Phase: Human Pharmacology (Phase I)- Other. Countries: Netherlands (authorised, recruitment pending).
Therapeutic area(s): Not possible to specify
Gender: Female, Male. Age: 18-64 years. Enrolment: 25.
Status: Authorised, recruitment pending. Decision date: 2026-05-22. Results received: No. Last updated: 2026-05-22.

Condition(s): Healthy volunteers

Source: https://euclinicaltrials.eu/ctis-public/view/2026-525788-42-00